EU clinical trial 2023-509436-26-00: A Phase II, Multicentre, Open-label, Master Protocol to Evaluate the Efficacy and Safety of Datopotamab Deruxtecan (Dato-DXd) as Monotherapy and in Combination with Anticancer Agents in Patients with Advanced/Metastatic Solid Tumours (TROPION-PanTumor03)
Protocol code: D926UC00001
Sponsor: AstraZeneca AB (Pharmaceutical company). Phase: Therapeutic exploratory (Phase II). Countries: Poland (ongoing, recruiting), France (ongoing, recruiting), Italy (ongoing, recruiting), Spain (ongoing, recruiting).
Therapeutic area(s): Diseases [C] - Neoplasms [C04]
Gender: Female, Male. Age: 18-64 years, 65+ years. Enrolment: 119.
Status: Ongoing, recruiting. Start date (EU): 2022-12-05. Decision date: 2024-06-24. Results received: No. Last updated: 2026-07-07.
Decision dates by country: FR: 2024-06-28, IT: 2024-07-01, ES: 2024-06-24, PL: 2024-07-15

Condition(s): Endometrial Cancer; Gastric Cancer; Metastatic Castration-resistant Prostate Cancer; Ovarian Cancer; Colorectal Cancer; Urothelial Cancer; Biliary Tract Cancer;
Product: CALCIUM FOLINATE, INFLIXIMAB, CAPECITABINE, Datopotamab deruxtecan, Rilvegostomig, CISPLATIN, BEVACIZUMAB, CAPECITABINE, FLUOROURACIL, PREDNISOLONE, CARBOPLATIN, MYCOPHENOLATE MOFETIL, volrustomig

Primary endpoint: Objective response rate (ORR), AEs/SAEs, ECOG performance status, changes from baseline in laboratory findings,ECGs, vital signs, physical examinations, and ophthalmologic assessments, PSA50 response (Substudy 3: Castration-resistant Prostate Cancer), Progression-free survival (PFS) (Substudy 4: Ovarian Cancer)
Endpoint(s): Progression-free survival (PFS), Duration of response (DoR), Disease control rate (DCR), Best percentage change in tumour size, Plasma concentrations and PK parameters, total anti-TROP2 antibody, and MAAA-1181a, Serum concentration of volrustomig and rilvegostomig (Substudy 6), Presence of ADAs for Dato-DXd (all Substudies), volrustomig and rilvegostomig (Substudy 6), Radiographic Progression-free survival (rPFS) (Substudy 3), Time to PSA progression (Substudy 3), CA-125 response (Substudy 4), OS (Overall survival) (Substudy 4)

Source: https://euclinicaltrials.eu/ctis-public/view/2023-509436-26-00